EU clinical trial 2024-518305-17-01: Pharmacokinetics of fluconazole given orally or intravenously as prophylaxis or therapy to children and adolescents with invasive fungal infections (FOCUS)
Protocol code: 112771
Sponsor: Radboud universitair medisch centrum Stichting (Hospital/Clinic/Other health care facility). Phase: Therapeutic use (Phase IV). Countries: Netherlands (ended).
Therapeutic area(s): Diseases [C] - Bacterial Infections and Mycoses [C01]
Gender: Female, Male. Age: 0-17 years. Enrolment: 30.
Status: Ended. Start date (EU): 2024-12-02. End date (EU): 2026-06-03. Decision date: 2024-12-02. Results received: No. Last updated: 2026-06-03.

Condition(s): Fungal infection
Product: Diflucan I.V. 2 mg/ml, oplossing voor infusie, Diflucan 10 mg/ml, poeder voor orale suspensie, Fluconazol Accord 50 mg capsules, hard, Diflucan 100 mg, capsule, hard

Primary endpoint: The primary objective of this study is to establish an improved fluconazole dosing regimen for paediatric and adolescent patients aged 2-18 years, we aim to describe fluconazole pharmacokinetics in this patient population by means of population pharmacokinetic (pop-PK) modelling. The pharmacokinetic parameters of the developed pop-PK model are among others, clearance (CL), volume of distribution (Vd) and exposure described by the area under the concentration-time curve (AUC).
Endpoint(s): Other study parameters are factors that might influence the primary study parameters, the covariates. Since this is an observational study, potential covariates will only be explored. Covariates of interest are renal clearance and body weight. Another study parameter that will be explored is the oral bioavailability (F) of fluconazole, which is the percentage of the drug that is systemically available after oral administration compared to the exposure after intravenous administration.

Source: https://euclinicaltrials.eu/ctis-public/view/2024-518305-17-01